EU clinical trial 2023-508649-42-00: NeoLIPA: A multi center phase II open label study of neoadjuvant LTX-315 in combination with pembrolizumab in patients with clinically detectable and resectable stage III-IV melanoma
Protocol code: NeoLIPA
Sponsor: Oslo University Hospital HF (Hospital/Clinic/Other health care facility). Phase: Therapeutic exploratory (Phase II). Countries: Norway (ongoing, recruiting).
Therapeutic area(s): Diseases [C] - Skin and Connective Tissue Diseases [C17]
Gender: Female, Male. Age: 18-64 years, 65+ years. Enrolment: 27.
Status: Ongoing, recruiting. Start date (EU): 2024-10-23. Decision date: 2024-04-24. Results received: No. Last updated: 2026-02-09.

Condition(s): Patients with clinically detectable and resectable stage III-IV melanoma

Primary endpoint: Rate of pathologic complete response (cPR)
Endpoint(s): Frequency, nature and severity of AE according to NCI CTCAE v 5.0: • All AEs • LTX-315 treatment-related AEs • Pembrolizumab treatment-related AEs The proportion of patients who received surgery as planned Number of doses of LTX-315 and pembrolizumab recieved, Objective response rate (ORR), i.e. rate of CR or PR as per RECIST version 1.1 prior to surgery Pathologic response rate (pCR + pPR) Rate of major pathologic response (MPR) defined as pCR and pnCR, Event free survival (EFS), defined as time from start of treatment to progression of disease per RECIST version 1.1 that precludes surgery, recurrence (local or distant) or death. Recurrence free survival (RFS), defined as the time from surgery to recurrence or death. Overall Survival (OS), Patient reported outcomes (PRO)

Source: https://euclinicaltrials.eu/ctis-public/view/2023-508649-42-00